EU clinical trial 2024-510995-18-00: An Open Label, Phase 1, Treatment Study to Evaluate the Safety, Pharmacokinetics and Pharmacodynamics of IDE397 (MAT2A Inhibitor) In Adult Participants with Advanced Solid Tumors.
Protocol code: IDE397-001
Sponsor: Ideaya Biosciences Inc. (Pharmaceutical company). Phase: Human Pharmacology (Phase I)- First administration to humans. Countries: Spain (ongoing, recruitment ended), Germany (ended), France (ongoing, recruitment ended).
Therapeutic area(s): Diseases [C] - Neoplasms [C04]
Gender: Female, Male. Age: 18-64 years, 65+ years. Enrolment: 45.
Start date (EU): 2023-03-01. Decision date: 2024-03-21. Results received: No. Last updated: 2026-02-09.
Decision dates by country: FR: 2024-03-25, DE: 2024-03-21, ES: 2024-04-24

Condition(s): Advanced Solid Tumors

Source: https://euclinicaltrials.eu/ctis-public/view/2024-510995-18-00